EU clinical trial 2023-507640-36-00: A Randomised, Double-Blind, Placebo-Controlled, Parallel Group Study to Assess the Effect of Baxdrostat on Ambulatory Blood Pressure in Participants with Resistant Hypertension.
Protocol code: Bax24 / D6970C00009
Sponsor: Astrazeneca AB (Pharmaceutical company). Phase: Therapeutic confirmatory (Phase III). Countries: Bulgaria (ended), Spain (ended), Slovakia (ended), Germany (ended), Hungary (ended), Greece (ended), Poland (ended), Belgium (ended), Czechia (ended).
Therapeutic area(s): Diseases [C] - Cardiovascular Diseases [C14]
Gender: Female, Male. Age: 18-64 years, 65+ years. Enrolment: 79.
Status: Ended. Start date (EU): 2024-04-29. End date (EU): 2025-08-08. End date: 2025-08-17. Decision date: 2024-04-05. Results received: Yes. Last updated: 2025-07-04.
Decision dates by country: DE: 2024-04-08, BG: 2024-04-15, BE: 2024-04-15, GR: 2024-04-12, HU: 2024-04-11, PL: 2024-04-12, SK: 2024-04-05, CZ: 2024-04-09, ES: 2024-04-11

Condition(s): Resistant hypertension (rHTN) defined as blood pressure that remains higher than goal levels despite the use of at least 3 anti hypertensive drugs of different classes at maximum tolerated dose, including a diuretic.
Product: Baxdrostat, Baxdrostat Placebo

Primary endpoint: Change from baseline in ambulatory 24‑hour average SBP at Week 12.
Endpoint(s): Change from baseline in ambulatory night-time average SBP at Week 12., Change from baseline in ambulatory daytime average SBP at Week 12., Change from baseline in seated SBP at Week 12., Participants achieving ambulatory 24-hour average SBP of < 130 mmHg at Week 12., Change from baseline in ambulatory 24-hour average DBP at Week 12., Change from baseline in ambulatory night-time average DBP at Week 12., Change from baseline in ambulatory daytime average DBP at Week 12., Change from baseline on seated DBP at Week 12., Participants achieving a nocturnal SBP dipping of ≥ 10% at Week 12

Source: https://euclinicaltrials.eu/ctis-public/view/2023-507640-36-00